EU clinical trial 2025-523590-42-00: A Phase 1/2, Multicenter, Open-label, Dose-escalation, and Dose-expansion Study to Evaluate the Safety, Pharmacokinetics, Pharmacodynamic, and Antitumor Activity of CR-001 in Adult Participants with Locally Advanced or Metastatic Solid Tumors.
Protocol code: CR-001-101
Sponsor: Crescent Biopharma Inc. (Pharmaceutical company). Phase: Phase I and Phase II (Integrated)- First administration to humans. Countries: Spain (authorised, recruiting), Ireland (authorised, recruitment pending), Italy (authorised, recruiting), France (authorised, recruitment pending), Romania (ongoing, recruiting).
Therapeutic area(s): Diseases [C] - Neoplasms [C04]
Gender: Female, Male. Age: 18-64 years, 65+ years. Enrolment: 180.
Start date (EU): 2026-06-11. Decision date: 2026-06-02. Results received: No. Last updated: 2026-07-15.
Decision dates by country: IE: 2026-06-05, RO: 2026-06-08, ES: 2026-06-08, FR: 2026-06-02, IT: 2026-06-04

Condition(s): Locally Advanced or Metastatic Solid Tumors
Product: CR-001

Primary endpoint: Incidence and nature of dose-limiting toxicities (DLTs) during Cycle 1 (28 days) of CR-001 administration, and maximum tolerated dose (MTD) characterization, if applicable, Incidence, nature, and severity of treatment-emergent adverse events (TEAEs) and treatment-emergent serious adverse events (SAEs), graded according to National Cancer Institute Common Terminology Criteria for Adverse Events (NCI CTCAE), Severity and nature of TEAEs leading to dose modifications and treatment discontinuation
Endpoint(s): Determination of RP2D(s): The RP2D will be determined based on a review of available safety, tolerability, PK, PD, and clinical activity data, Serum PK parameters: area under the curve from time 0 extrapolated to infinity (AUC0--inf), area under the concentration-time curve from time 0 to the time of the last quantifiable concentration (AUClast), maximum concentration (Cmax), time to maximum concentration (Tmax), volume of distribution (Vd), clearance (CL), and elimination half-life (t½) after a single dose and steady state PK parameters as appropriate, Incidence of participants with detectable antidrug antibodies (ADAs), Overall response rate (ORR), duration of response (DOR), disease control rate (DCR), time to response (TTR) progression-free survival (PFS), overall survival (OS), and best percent change in target lesions

Source: https://euclinicaltrials.eu/ctis-public/view/2025-523590-42-00